EU clinical trial 2024-512999-35-00: LOGICAN : Randomised phase II study evaluating trifluridine/tipiracil plus oxaliplatin ± nivolumab versus FOLFOX ± nivolumab in patients with HER2 negative locally advanced, recurrent or metastatic gastric, oesophageal or junctional adenocarcinoma
Protocol code: UC-GIG-2023
Sponsor: Unicancer (Hospital/Clinic/Other health care facility). Phase: Therapeutic exploratory (Phase II). Countries: France (ongoing, recruiting).
Therapeutic area(s): Diseases [C] - Neoplasms [C04]
Gender: Female, Male. Age: 18-64 years, 65+ years. Enrolment: 118.
Status: Ongoing, recruiting. Start date (EU): 2023-06-23. Decision date: 2024-06-20. Results received: No. Last updated: 2025-12-11.

Condition(s): Patients with HER 2 negative locally advanced, recurrent or metastatic gastric, oesophagus or gastroesophageal junction adenocarcinoma
Product: CAPECITABINE, Lonsurf 15 mg/6.14 mg film-coated tablets, FOLINIC ACID, FLUOROURACIL, OXALIPLATIN, NIVOLUMAB, Lonsurf 20 mg/8.19 mg film-coated tablets, LEVOLEUCOVORIN

Primary endpoint: PFS defined as the time from the date of randomisation to date of disease progression (radiological or clinical) or death from any cause, whichever occurs first. Patients without tumour progression or death at the time of analysis will be censored at the date of their last tumour assessment.
Endpoint(s): Efficacy endpoints:ORR (according to RECIST v1.1) defined as the percentage of patients with Complete Response (CR) or Partial Response (PR). Patients who discontinue treatment without a tumour assessment will be considered non-responders for the analysis, Efficacy endpoints : Overall survival (OS), defined as the time from date of randomisation to the date of death from any cause. Patients alive at the database cut-off date will be censored at the last date of follow-up., Safety and tolerability of treatment (NCI-CTCAE version 5.0) determined through the incidence of adverse events, treatment related adverse events, serious adverse Events (SAE), and death., Time to PS deterioration >2 defined as the time between patient randomisation and the first date when PS>2, Quality of Life (QoL) according to QLQ-C30 questionnaire

Source: https://euclinicaltrials.eu/ctis-public/view/2024-512999-35-00